EU clinical trial 2024-518813-24-00: First-In-Human study evaluating the Safety of administration of ABD-3001 to Patients with Relapsed/Refractory Acute Myeloid Leukemia or High/Very-high Risk Myelodysplastic Syndromes
Protocol code: ODYSSEY
Sponsor: Advanced Biodesign (Pharmaceutical company). Phase: Human Pharmacology (Phase I)- First administration to humans. Countries: France (ongoing, recruiting).
Therapeutic area(s): Diseases [C] - Neoplasms [C04]
Gender: Female, Male. Age: 18-64 years, 65+ years. Enrolment: 61.
Status: Ongoing, recruiting. Start date (EU): 2024-11-12. Decision date: 2024-11-12. Results received: No. Last updated: 2026-03-18.

Condition(s): Patients with Relapsed/Refractory Acute Myeloid Leukemia or High/Very-high Risk Myelodysplastic Syndromes, Ineligible for Intensiveor New Generation Targeted Therapy

Source: https://euclinicaltrials.eu/ctis-public/view/2024-518813-24-00